EU clinical trial 2024-516295-14-00: A Phase 2, Multicenter, Randomized, Double-blind, Placebo-controlled Trial to Evaluate the Efficacy and Safety of Sibeprenlimab Administered Subcutaneously in Participants with Sjögren’s Disease.
Protocol code: 417-201-00042
Sponsor: Otsuka Pharmaceutical Development & Commercialization Inc. (Pharmaceutical company). Phase: Therapeutic exploratory (Phase II). Countries: Spain (ongoing, recruitment ended), Germany (ended), Greece (ongoing, recruitment ended), Poland (ongoing, recruitment ended), Bulgaria (ongoing, recruitment ended), Romania (ongoing, recruitment ended).
Therapeutic area(s): Diseases [C] - Immune System Diseases [C20]; Diseases [C] - Eye Diseases [C11]
Gender: Female, Male. Age: 18-64 years, 65+ years. Enrolment: 40.
Start date (EU): 2025-09-17. Decision date: 2025-04-22. Results received: No. Last updated: 2026-01-26.
Decision dates by country: DE: 2025-04-23, ES: 2025-04-22, RO: 2025-04-29, BG: 2025-04-23, GR: 2025-04-22, PL: 2025-04-27

Condition(s): Treatment of Sjögren’s disease
Product: Sibeprenlimab, Sibeprenlimab placebo

Primary endpoint: Change from baseline in ESSDAI score at 28 weeks
Endpoint(s): Change from baseline in ESSPRI score at 28 weeks, Incidence of TEAEs graded by severity, injection site reactions, clinical laboratory tests, vital sign measurements, and physical examinations, Proportion of participants with minimal clinical improvement at 28 weeks defined as ESSDAI reduction ≥ 3 points from baseline, Proportion of participants with minimal clinical improvement at 28 weeks defined as ESSPRI reduction ≥ 1 point from baseline, Change from baseline in individual ESSDAI domains at 28 weeks, Change from baseline at 28 weeks in the: Salivary flow rate Tear flow rate, Change from baseline at 28 weeks for the following: ClinESSDAI score PhGA score of disease activity PaGA score of participant outcomes FACIT-Fatigue score SF-36v2 Physical Component Summary Scale score and Mental Component Summary Scale score Patient-reported Sjögren’s disease diary score (symptom and impact), Proportion of participants with minimal clinical improvement, defined as FACIT-Fatigue score increase of ≥ 4 from baseline, at 28 weeks, Time to the first occurrence of minimal clinical improvement in ESSDAI by Week 28, Time to the first occurrence of minimal clinical improvement in ESSPRI by Week 28, Percent change from baseline to Week 28 in total serum IgA, IgG, IgM, and free APRIL concentrations, Evaluation of PK profile, Evaluation of serum ADA

Source: https://euclinicaltrials.eu/ctis-public/view/2024-516295-14-00